EU clinical trial 2022-502994-40-00: J3P-MC-FTAF: An Adaptive Phase 2a/2b, Randomized, Double-Blind, Placebo-Controlled Study of LY3871801 in Adult Participants With Moderately-to-Severely Active Rheumatoid Arthritis
Sponsor: Eli Lilly & Co. (Pharmaceutical company). Phase: Therapeutic exploratory (Phase II). Countries: France (ended), Czechia (ended), Slovakia (ended), Germany (ended), Hungary (ended), Poland (ended).
Therapeutic area(s): Diseases [C] - Musculoskeletal Diseases [C05]
Gender: Female, Male. Age: 18-64 years, 65+ years. Enrolment: 62.
Status: Ended. Start date (EU): 2023-09-04. End date (EU): 2026-04-22. End date: 2026-04-23. Decision date: 2023-08-08. Results received: No. Last updated: 2026-06-19.
Decision dates by country: SK: 2023-08-08, FR: 2023-08-14, DE: 2023-08-09, PL: 2025-01-11, HU: 2024-11-19, CZ: 2023-08-08

Condition(s): Rheumatoid Arthritis
Product: LY3871801_25g, Placebo to match LY3871801

Primary endpoint: Phase 2a: Change from Baseline in Disease Activity Score – high-sensitivity C-reactive protein (DAS28-hsCRP), Phase 2b: Percentage of Participants Achieving American College of Rheumatology (ACR)50

Source: https://euclinicaltrials.eu/ctis-public/view/2022-502994-40-00